EU clinical trial 2025-524442-10-00: Achieving viral CLEARance in immunocompromised participants with long-term persistence of SARS-CoV-2 - an open-label randomized trial (CLEAR)
Protocol code: CLEAR
Sponsor: Goethe University Frankfurt (Educational Institution). Phase: Therapeutic exploratory (Phase II). Countries: Germany (authorised, recruitment pending), Spain (authorised, recruitment pending).
Therapeutic area(s): Diseases [C] - Virus Diseases [C02]
Gender: Female, Male. Age: 18-64 years, 65+ years. Enrolment: 24.
Status: Authorised, recruitment pending. Decision date: 2026-07-13. Results received: No. Last updated: 2026-07-24.
Decision dates by country: DE: 2026-07-13, ES: 2026-07-24

Condition(s): Long-term persistence of SARS-CoV-2
Product: Paxlovid 150 mg + 100 mg film-coated tablets, Veklury 100 mg powder for concentrate for solution for infusion

Primary endpoint: Percent of participants from group B with absence of SARSCoV- 2 (CT value > 30) from a combined nose/throat swab at day 15 and day 22. For reaching the endpoint, test results from both days need to be negative.
Endpoint(s): a) Percentage of participants with treatment-emergent AEs (TEAEs). b) Percentage of participants with SAEs in groups A and B. c) Percentage of participants with early treatment discontinuation in groups A and B., % participants from group A with absence of SARS-CoV-2 from a combined nose/throat swab at day 15 and day 22., % of severely immunocompromised participants from group A and B with absence of SARS-CoV-2 from a combined nose/throat swab at day 15 and day 22, Assessment of SARS-CoV-2 RNA in combined nose/throat swabs at baseline. In participants with measurable baseline levels, changes from baseline to days 5, 15, 22, and 50 will be assessed., Mean time to first negative SARS-CoV-2 PCR (CT value > 30) in each group., Acute COVID-19 signs and symptoms diary and Global Impression Questions: a) Change in % of patients in each response category from baseline to days 5, 10, 15, 22, and 50. b) Worsening status or new onset of symptoms in 1 or more categories from baseline to days 5, 10, 15, 22, and 50, a) Proportion of participants admitted to the intensive care unit by Day 50. b) All-cause mortality at day 50.

Source: https://euclinicaltrials.eu/ctis-public/view/2025-524442-10-00